EU clinical trial 2023-507132-21-00: A Phase IIb, Randomized, Double-Blind, Placebo-Controlled, Multicenter Study to Evaluate the Efficacy and Safety of Intravenous Prasinezumab in Participants with Early Parkinson's Disease
Protocol code: BN42358
Sponsor: F. Hoffmann-La Roche AG (Pharmaceutical company). Phase: Phase II and Phase III (Integrated). Countries: Poland (ongoing, recruitment ended), Luxembourg (ongoing, recruitment ended), France (ongoing, recruitment ended), Austria (ongoing, recruitment ended), Italy (ongoing, recruitment ended), Spain (ongoing, recruitment ended).
Therapeutic area(s): Diseases [C] - Nervous System Diseases [C10]
Gender: Female, Male. Age: 18-64 years, 65+ years. Enrolment: 398.
Status: Ongoing, recruitment ended. Start date (EU): 2021-05-11. Decision date: 2024-07-18. Results received: No. Last updated: 2026-07-27.
Decision dates by country: AT: 2024-07-22, PL: 2024-07-18, ES: 2024-09-26, FR: 2024-07-22, LU: 2024-08-05, IT: 2024-08-12

Condition(s): Early Parkinson's disease
Product: RO7046015, RO7046015, RO7046015 Placebo

Primary endpoint: 1. Time to confirmed motor progression event
Endpoint(s): 1. Time-to-worsening of patient’s motor function as reported by the patient in MDS-UPDRS Part II and in the presence of a confirmed motor progression event, 2. Time to meaningful worsening in Patient Global Impression of Change (PGI-C, Overall Disease Subscale), 3. Time to meaningful worsening in Clinician Global Impression of Change (CGI-C, Overall Disease Subscale), 4. Change in motor function from baseline to Week 76, as measured by the MDS-UPDRS Part III score, 5. Change in bradykinesia and rigidity from baseline to Week 76, as measured by the MDS-UPDRS Part III bradykinesia and rigidity subscore, 6. Time to onset of motor complications as assessed through MDS-UPDRS Part IV, 7. Nature, Incidence, seriousness and severity of adverse events, with severity determined according to National Cancer Institute Common Terminology Criteria for Adverse Events, Version 5.0 (NCI CTCAE v5.0), 8. Incidence of adverse events of special interest, 9. Incidence of treatment discontinuation due to adverse events, 10. Nature, Incidence, seriousness and severity of infusion-related reactions (IRRs), 11. Change from baseline in vital signs, 12. Incidence of abnormal vital sign measurements, 13. Change from baseline in electrocardiogram (ECG) assessments, 14. Incidence of abnormal ECG assessments, 15. Change from baseline in laboratory measurements, 16. Incidence of abnormal laboratory measurements, 17. Incidence of physical and neurologic examination abnormalities, 18. Change from baseline in suicidal ideation, as measured by the Columbia-Suicide Severity Rating Scale (C-SSRS), 19. Serum concentration of prasinezumab at specified timepoints, 20. Prevalence of anti-drug antibodies (ADAs) against prasinezumab at baseline, 21. Incidence of ADAs against prasinezumab during the study

Source: https://euclinicaltrials.eu/ctis-public/view/2023-507132-21-00